EU clinical trial 2023-505220-57-03: Pancreatitis and early omega-3-fatty acid infusion for reduction of organ failure and mortality: a multicenter randomized controlled trial (PLANCTON).
Sponsor: Stichting Radboud University Medical Center (Hospital/Clinic/Other health care facility). Phase: Therapeutic confirmatory (Phase III). Countries: Netherlands (ongoing, recruiting), Denmark (ongoing, recruiting).
Therapeutic area(s): Diseases [C] - Digestive System Diseases [C06]
Gender: Female, Male. Age: 18-64 years, 65+ years. Enrolment: 232.
Status: Ongoing, recruiting. Start date (EU): 2022-05-09. Decision date: 2023-11-08. Results received: No. Last updated: 2026-07-01.
Decision dates by country: DK: 2024-11-18, NL: 2023-11-08

Condition(s): Predicted severe acute pancreatitis
Product: Omegaven, infusiooniemulsion

Primary endpoint: Endpoints will be evaluated after the 180 days study period. The primary endpoint is a composite endpoint of new organ failure (cardiovascular, pulmonary or renal) and mortality. Definitions New onset organ failure is defined as organ failure that was not present at randomization. Organ failure is addressed according to the modified Marshall score
Endpoint(s): Individual components of the primary outcome, Mortality (during follow-up): 14-day mortality or 28-day mortality or In hospital mortality, New onset organ failure (during follow-up), Infectious complications (i.e. pneumonia, urinary tract, wound infections or infected (peri-) pancreatic necrosis), The need (and number of) for surgical, endoscopical or radiologic interventions, CRP level on day 0, 1, 2, 3, 5 and 7, Total length of hospital stay (days), Total length of ICU stay (days)

Source: https://euclinicaltrials.eu/ctis-public/view/2023-505220-57-03